EU clinical trial 2024-512187-57-00: A study to determine if BHV-2100 and BHV-7000 are effective, safe, and tolerable as a pain medication in healthy male participants
Protocol code: BHV2100-112
Sponsor: Biohaven Therapeutics Ltd. (Pharmaceutical company). Phase: Human Pharmacology (Phase I)- Other. Countries: Germany (ended).
Therapeutic area(s): Diseases [C] - Nervous System Diseases [C10]
Gender: Male. Age: 18-64 years. Enrolment: 24.
Status: Ended. Start date (EU): 2024-10-07. End date (EU): 2024-12-10. End date: 2024-12-11. Decision date: 2024-08-20. Results received: No. Last updated: 2024-10-24.

Condition(s): Pain

Source: https://euclinicaltrials.eu/ctis-public/view/2024-512187-57-00